EU clinical trial 2024-515234-33-00: An open-label extension multi-centre trial in adult subjects diagnosed with Type 1 diabetes mellitus exploring the effect of long-term Verapamil SR therapy on the preservation of beta-cell function.
Protocol code: Ver-A-Long
Sponsor: Medical University Of Graz (Educational Institution). Phase: Therapeutic exploratory (Phase II). Countries: France (ongoing, recruitment ended), Belgium (ongoing, recruitment ended), Austria (ongoing, recruitment ended), Germany (ongoing, recruitment ended), Italy (ongoing, recruitment ended).
Therapeutic area(s): Phenomena and Processes [G] - Metabolism [G03]
Gender: Female, Male. Age: 18-64 years. Enrolment: 19.
Status: Ongoing, recruitment ended. Start date (EU): 2024-11-21. Decision date: 2024-11-11. Results received: No. Last updated: 2024-11-18.
Decision dates by country: AT: 2024-11-18, BE: 2024-11-11, FR: 2024-11-13, DE: 2024-11-15, IT: 2024-11-14

Condition(s): Type 1 diabetes mellitus (T1D)
Product: Vera-Til SR 120mg Tablets, ISOPTINE L.P. 240 mg, comprimé pelliculé sécable à libération prolongée, Verapamil 120 ret - 1A-Pharma 120 mg Retardtabletten, VeraHEXAL® KHK 120 mg retard, Retardtabletten, Isoptin® retard 120 mg - Filmtabletten, LODIXAL 240 mg, Tabletten met verlengde afgifte, VERAPAMIL DOC Generici 120 mg capsule rigide a rilascio prolungato, VERAPAMIL HEXAL 120 mg compresse a rilascio prolungato, Isoptin® KHK retard 120 mg, Retardtabletten, Half Securon SR, Verapamil Hennig 120 mg retard Retardtabletten

Primary endpoint: Change over time in C-peptide Area under the curve (C-pep AUC % change) in adults diagnosed with T1D receiving 360 mg oral Verapamil daily undergoing MMTT, measured at baseline (V-1) and 24 months of therapy (V8)
Endpoint(s): Changes over time in C-peptide Area under the curve (C-pep AUC % change) in adults diagnosed with T1D receiving 360 mg oral Verapamil Option 2 Fig. 2a Option 2 Fig. 2b EU CT Number:2024-515234-33-00 Page 15 of 59 Protocol Short Title Ver-A-Long Version Number: 2.0 Version Date: 12.06.2024 daily undergoing MMTT, measured at 6-, 12-, and 18 months of therapy (V5 to V7), Changes over time in blood glucose control as assessed by HbA1C in adults diagnosed with T1D receiving 360 mg oral Verapamil daily, measured at baseline (V-1) and 6-, 12-, 18- and 24 months of therapy (V5 to V8), Changes over time in insulin requirements as the total daily insulin dose (seven days average) in units per kg body weight (BW) in adults diagnosed with T1D receiving 360 mg oral Verapamil SR once daily, assessed at baseline (V-1) and 6-, 12- 18- and 24 months of therapy (V5 to V8), The number of treatment emergent severe hypoglycaemic episodes. Severe hypoglycaemia denotes severe cognitive impairment requiring external assistance for recovery according to the American Diabetes Association (ADA), The number of treatment emergent episodes of diabetic ketoacidosis (DKA)., Adverse events, vital signs variation, ECG, laboratory safety parameters, measured at baseline (V-1) and 6-, 12- 18- and 24 of therapy (V5 to V8)

Source: https://euclinicaltrials.eu/ctis-public/view/2024-515234-33-00